EU clinical trial 2025-524775-23-00: Evaluation of bioequivalence of two products containing estradiol: Estradiol/INTERMED gel 0.1% w/w (Test) vs. ESTREVA 0.1% gel (Comparator). An open, randomized, single-dose, four-period, full-replicative trial in healthy postmenopausal women
Protocol code: CIM25001
Sponsor: CCDRD Cooperative Clinical Drug Research and Development AG, Ioulia And Irene Tseti Pharmaceutical Laboratories S.A. (Pharmaceutical company). Phase: Human Pharmacology (Phase I)- Bioequivalence Study. Countries: Bulgaria (authorised, recruitment pending).
Therapeutic area(s): Phenomena and Processes [G] - Physiological processes [G07]
Gender: Female. Age: 18-64 years. Enrolment: 140.
Status: Authorised, recruitment pending. Decision date: 2026-06-30. Results received: No. Last updated: 2026-06-30.

Condition(s): No therapeutic indication in the current trial with healthy volunteers.

Source: https://euclinicaltrials.eu/ctis-public/view/2025-524775-23-00